EU clinical trial 2026-525864-17-00: Trial to study the safety, pharmacokinetics and preliminary antitumour activity of ODM-216 in patients with cancer
Protocol code: 3138001
Sponsor: Orion Corporation (Pharmaceutical company). Phase: Phase I and Phase II (Integrated)- First administration to humans. Countries: Spain (authorised, recruitment pending).
Therapeutic area(s): Diseases [C] - Neoplasms [C04]
Gender: Female, Male. Age: 18-64 years, 65+ years. Enrolment: 104.
Status: Authorised, recruitment pending. Decision date: 2026-08-06. Results received: No. Last updated: 2026-08-06.

Condition(s): Advanced solid tumours

Source: https://euclinicaltrials.eu/ctis-public/view/2026-525864-17-00